EU clinical trial 2022-501105-12-00: C5731001 - An Open-label, Randomized, Controlled Phase 3 Study of Disitamab Vedotin in Combination with Pembrolizumab Versus Chemotherapy in Subjects with Previously Untreated Locally Advanced or Metastatic Urothelial Carcinoma that Expresses HER2 (IHC 1+ and Greater)
Protocol code: SGNDV-001/KN-D74
Sponsor: Seagen Inc. (Pharmaceutical company). Phase: Therapeutic confirmatory (Phase III). Countries: Czechia (ongoing, recruitment ended), Belgium (ongoing, recruitment ended), France (ongoing, recruitment ended), Netherlands (ongoing, recruitment ended), Ireland (ongoing, recruitment ended), Sweden (ongoing, recruitment ended), Greece (ongoing, recruitment ended), Hungary (ongoing, recruitment ended), Norway (ended), Austria (ended), Spain (ongoing, recruitment ended), Italy (ongoing, recruitment ended), Portugal (ongoing, recruitment ended).
Therapeutic area(s): Diseases [C] - Neoplasms [C04]
Gender: Female, Male. Age: 18-64 years, 65+ years. Enrolment: 98.
Start date (EU): 2024-07-15. Decision date: 2024-06-12. Results received: No. Last updated: 2026-08-05.
Decision dates by country: AT: 2024-10-23, NO: 2024-06-14, CZ: 2024-06-12, FR: 2024-06-12, GR: 2024-06-17, HU: 2024-06-13, IE: 2024-06-14, IT: 2024-06-14, PT: 2024-06-12, ES: 2024-06-12, SE: 2024-06-14, NL: 2024-06-17, BE: 2024-06-12

Condition(s): Urothelial Carcinoma
Product: GEMCITABINE, CISPLATIN, CARBOPLATIN, KEYTRUDA 25 mg/mL concentrate for solution for infusion, Disitamab Vedotin

Primary endpoint: PFS per Response Evaluation Criteria in Solid Tumors (RECIST) version (v)1.1 by blinded independent central review (BICR), Overall survival (OS)
Endpoint(s): ORR per RECIST v1.1 by BICR, ORR per RECIST v1.1 by investigator assessment, DOR per RECIST v1.1 by BICR, DOR per RECIST v1.1 by investigator, DCR per RECIST v1.1 by BICR, DCR per RECIST v1.1 by investigator, PFS per RECIST v1.1 by investigator, Type, incidence, relatedness, severity, and seriousness of adverse events (AEs), Type, incidence, and severity of laboratory abnormalities, Treatment discontinuation rate due to AEs, Electrocardiogram abnormalities, including changes in QTc, Effect on left ventricular ejection fraction, Change from baseline to Week 16 in European Organisation for Research and Treatment of Cancer core QoL questionnaire (EORTC QLQ C30) Global Health Status (GHS)/QoL Score (Items 29+30), Time to Deterioration in EORTC QLQ-C30 GHS/QoL Score (Items 29 + 30), Time to pain progression

Source: https://euclinicaltrials.eu/ctis-public/view/2022-501105-12-00